EU clinical trial 2023-508101-24-00: LBL 2018 - International cooperative treatment protocol for children and adolescents with lymphoblastic lymphoma
Protocol code: UKM17_0023
Sponsor: Universitaetsklinikum Muenster AöR (Hospital/Clinic/Other health care facility). Phase: Therapeutic confirmatory (Phase III). Countries: Poland (ongoing, recruiting), Italy (ongoing, recruiting), Denmark (ongoing, recruiting), Czechia (ongoing, recruiting), Germany (ongoing, recruiting), Slovakia (ongoing, recruiting), Finland (ongoing, recruiting), Netherlands (ongoing, recruiting), Norway (ongoing, recruiting), Spain (ongoing, recruiting), Sweden (ongoing, recruiting), Belgium (ongoing, recruiting), Austria (ongoing, recruiting), Hungary (ongoing, recruiting).
Therapeutic area(s): Diseases [C] - Neoplasms [C04]
Gender: Female, Male. Age: 0-17 years. Enrolment: 544.
Status: Ongoing, recruiting. Start date (EU): 2019-08-01. Decision date: 2024-04-09. Results received: No. Last updated: 2026-04-08.
Decision dates by country: NO: 2024-04-15, BE: 2024-04-17, SE: 2024-04-09, NL: 2024-04-12, CZ: 2024-04-10, SK: 2024-04-09, IT: 2024-04-11, PL: 2024-04-16, FI: 2024-04-10, ES: 2024-04-12, AT: 2024-04-15, DK: 2024-04-10, HU: 2024-04-12, DE: 2024-04-10

Condition(s): Lymphoblastic lymphoma
Product: METHOTREXATE, VINCRISTINE, CYTARABINE, DAUNORUBICIN, VINDESINE, PEGASPARGASE, IFOSFAMIDE, CYCLOPHOSPHAMIDE, MERCAPTOPURINE, TIOGUANINE, DOXORUBICIN, DEXAMETHASONE, PREDNISOLONE, PREDNISONE

Primary endpoint: Primary endpoints of randomization 1: For the randomized question 1 the cumulative incidence of relapse with involvement of the CNS (CNS-relapse, pCICR) is the primary endpoint., Primary endpoints of randomization 2: For the randomized question 2 the estimated probability of event-free survival (pEFS) is the primary endpoint.

Source: https://euclinicaltrials.eu/ctis-public/view/2023-508101-24-00